EU clinical trial 2024-511750-53-00: A Phase 1/2, Multicenter, Open Label, Dose Escalation & Dose Expansion Study of JK08, an IL-15 Antibody Fusion Protein Targeting CTLA-4, Monotherapy or in Combination in Patients with Unresectable Locally Advanced or Metastatic Cancer
Protocol code: JK08.1.01
Sponsor: Salubris Biotherapeutics Inc. (Pharmaceutical company). Phase: Phase I and Phase II (Integrated)- First administration to humans. Countries: Spain (ended), Belgium (ended).
Therapeutic area(s): Diseases [C] - Neoplasms [C04]
Gender: Female, Male. Age: 18-64 years, 65+ years. Enrolment: 130.
Status: Ended. Start date (EU): 2022-09-08. End date (EU): 2025-04-25. End date: 2025-04-26. Decision date: 2024-05-06. Results received: Yes. Last updated: 2025-02-14.
Decision dates by country: ES: 2024-05-06, BE: 2024-05-06

Condition(s): Unresectable Locally Advanced or Metastatic Cancer
Product: KEYTRUDA 25 mg/mL concentrate for solution for infusion, LENVIMA 4 mg hard capsules

Primary endpoint: MTD and/or DLT after one cycle of treatment and all SAEs, AEs tabulated/reported by type, grade, and frequency for the entire study duration.
Endpoint(s): PK (analysis of Cmax, AUC, tmax, and t½ following treatment completion)., ADA status., ORR according to standard RECIST 1.1 criteria., DCR and PFS by RECIST 1.1 and OS in patients with advanced solid tumors.

Source: https://euclinicaltrials.eu/ctis-public/view/2024-511750-53-00